EU clinical trial 2024-515246-17-00: Randomized clinical trial comparing the diagnostic quality and diagnostic accuracy of pulmonary CT angiography performed with spectral CT among three iodinated contrast administration protocols, with 20, 30 and 40 mL
Sponsor: Hospital General Universitario Dr. Balmis (Hospital/Clinic/Other health care facility). Phase: Therapeutic use (Phase IV). Countries: Spain (ended).
Therapeutic area(s): Analytical, Diagnostic and Therapeutic Techniques and Equipment [E] - Diagnosis [E01]
Gender: Female, Male. Age: 18-64 years, 65+ years. Enrolment: 150.
Status: Ended. Start date (EU): 2024-11-11. End date (EU): 2025-08-01. Decision date: 2024-10-16. Results received: Yes. Last updated: 2024-10-16.

Condition(s): pulmonary embolism
Product: Iomeron 400 mgI/ml solution for injection

Primary endpoint: Attenuation achieved in the pulmonary arteries at conventional and low-energy monoenergetic images, Detection of pulmonary thromboembolism, Lung perfusion based in iodine density.

Source: https://euclinicaltrials.eu/ctis-public/view/2024-515246-17-00